EU clinical trial 2024-519149-31-00: Tolerability and acceptance study of two oral hydrocortisone magistral formulations for pediatrics
Protocol code: HIDROGUM21
Sponsor: Fundacio Hospital Universitari Vall D’Hebron Institut De Recerca (Laboratory/Research/Testing facility). Phase: Therapeutic use (Phase IV). Countries: Spain (authorised, recruitment pending).
Therapeutic area(s): Diseases [C] - Hormonal diseases [C19]
Gender: Female, Male. Age: 0-17 years. Enrolment: 35.
Status: Authorised, recruitment pending. Decision date: 2024-10-31. Results received: No. Last updated: 2024-10-31.

Condition(s): Adrenal hyperplasia or isolated primary adrenal insufficiency or panhypopituitarism (secondary or tertiary adrenal insufficiency).
Product: HYDROCORTISONE PH. EUR., HYDROCORTISONE PH. EUR.

Primary endpoint: The sensory acceptability of the formulation.

Source: https://euclinicaltrials.eu/ctis-public/view/2024-519149-31-00